EU clinical trial 2024-512095-35-00: Phase I/II multicenter study to assess efficacy and safety of ribociclib (LEE011) in combination with topotecan and temozolomide (TOTEM) in pediatric patients with relapsed or refractory neuroblastoma and other solid tumors
Protocol code: CLEE011Q12101
Sponsor: Novartis Pharma AG (Pharmaceutical company). Phase: Phase I and Phase II (Integrated)- Other. Countries: Spain (ended), Germany (ended), France (ended), Denmark (ended), Hungary (ended), Czechia (ended), Italy (ended).
Therapeutic area(s): Diseases [C] - Neoplasms [C04]
Gender: Female, Male. Age: 0-17 years, 18-64 years. Enrolment: 49.
Status: Ended. Start date (EU): 2022-12-27. End date (EU): 2025-02-13. End date: 2025-02-26. Decision date: 2024-04-19. Results received: Yes. Last updated: 2025-02-26.
Decision dates by country: CZ: 2024-04-19, DK: 2024-04-19, FR: 2024-04-24, DE: 2024-04-23, HU: 2024-04-19, IT: 2024-05-22, ES: 2024-04-22

Condition(s): Relapsed or refractory neuroblastoma and other solid tumors (including medulloblastoma, high grade glioma, malignant rhabdoid tumors, and rhabdomyosarcoma)
Product: TOPOTECAN HYDROCHLORIDE, TOPOTECAN HYDROCHLORIDE, TEMOZOLOMIDE, TEMOZOLOMIDE, TEMOZOLOMIDE, TEMOZOLOMIDE, LEE011, TEMOZOLOMIDE, TEMOZOLOMIDE

Primary endpoint: Phase I – part A: Incidence of Dose Limiting Toxicities (DLTs) in Cycle 1 (28-Day cycle), Phase I – part B: ORR (percentage of participants with confirmed best overall of CR or PR) as assessed by Blinded Independent Review Committee (BIRC) per Revised Assessment in Neuro-Oncology (RANO) criteria for participants with high-grade glioma (HGG), International Neuroblastoma Response Criteria (INRC) for participants with neuroblastoma (NB), response evaluation criteria in solid tumors (RECIST) version 1.1 for participants with medulloblastoma, malignant rhabdoid tumor and rhabdomyosarcoma, Phase II: ORR (percentage of participants with confirmed best overall confirmed CR or PR) as assessed by BIRC using INRC
Endpoint(s): Phase I – part A: Safety: Incidence, type, and severity of adverse events (AEs) per common terminology criteria for adverse events (CTCAE) version 5.0 including changes in laboratory values, performance status, vital signs, liver assessments, cardiac assessments, and incidence of DLTs in Cycle 1. Tolerability: dose interruptions, reductions, dose intensity, and duration of exposure for all treatment components., Phase I – part A: Plasma concentrations of ribociclib and derived PK parameters such as AUC, Cmax, Tmax., Phase I – part B: DOR, PFS, TTR per RANO criteria for participants with HGG, INRC for participants with NB, RECIST 1.1 for participants with MB, MRT and RMS as assessed by BIRC assessment, and OS., Phase I – part B: Safety: Incidence, type, and severity of AEs per CTCAE version 5.0 including changes in laboratory values, performance status, vital signs, liver assessments, cardiac assessments and incidence of DLTs in Cycle 1. Tolerability: dose interruptions, reductions, dose intensity, and duration of exposure for all treatment components., Phase I – part B: Plasma concentrations of ribociclib and derived PK parameters such as AUC, Cmax, Tmax., Phase II: PFS and DOR using INRC as assessed by BIRC (key secondary endpoints). TTR, CBR using INRC as assessed by BIRC and OS, Phase II: Plasma concentrations of ribociclib, topotecan, temozolomide and derived PK parameters of ribociclib such as AUC and Cmax., Phase II: Safety: Incidence, type, and severity of adverse events per CTCAE version 5.0 criteria including changes in laboratory values, performance status, vital signs, liver assessments and cardiac assessments. Tolerability: dose interruptions, reductions, dose intensity, and duration of exposure for all treatment components., Phase II: PRO as measured by the Pediatric Quality of Life Inventory (PedsQL) questionnaire.

Source: https://euclinicaltrials.eu/ctis-public/view/2024-512095-35-00